EU clinical trial 2023-510432-36-00: A MULTICENTRIC PHASE 2 STUDY OF VENETOCLAX AND AZACITIDINE FOR THE MANAGEMENT OF MOLECULAR RELAPSE/PROGRESSION IN ADULT NPM1-MUTATED ACUTE MYELOID LEUKEMIA. AML2521
Protocol code: AML2521
Sponsor: Fondazione Gimema Franco Mandelli Onlus (Patient organisation/association). Phase: Therapeutic exploratory (Phase II). Countries: Italy (ongoing, recruitment ended).
Therapeutic area(s): Diseases [C] - Hemic and Lymphatic Diseases [C15]
Gender: Female, Male. Age: 18-64 years, 65+ years. Enrolment: 35.
Status: Ongoing, recruitment ended. Start date (EU): 2022-03-01. Decision date: 2024-07-04. Results received: No. Last updated: 2026-01-19.

Condition(s): Acute Myeloid Leukemia with NPM1 mutation
Product: VENETOCLAX, VENETOCLAX, VENETOCLAX, AZACITIDINE

Primary endpoint: Percentage of patients who do not experience overt relapse at 6 months or within stem cell transplant
Endpoint(s): MRD negativity rate at 3 and 6 months and at transplant, Percentage of patients undergoing alloSCT in CR, Percentage of patients undergoing alloSCT in MRD negativity, Disease Progression rate at 3, 6 and 12 months and at transplant, Molecular Disease Progression at 3, 6 and 12 months and at transplant, Overall Survival (OS), defined as the number of days between the first study drug administration and death from any cause or lost to follow up., Progression-Free Survival (PFS), defined as the number of days between the first study drug administration and any event including disease progression or death., Molecular Disease-Free Survival (MDFS), defined as the number of days between the data of response (MRD negativity) and molecular disease progression or death., Molecular progression-free survival (MPFS), defined as the number of days between the first study drug administration and molecular disease progression or death., Safety and toxicity of venetoclax-azacitidine in the experimental setting

Source: https://euclinicaltrials.eu/ctis-public/view/2023-510432-36-00